EU clinical trial 2024-518148-19-00: EFFICACY OF USUAL MANAGEMENT BY LOCAL ANESTHETIC INFILTRATION IN THE TREATMENT OF CHRONIC IDIOPATHIC ANO-PERINEAL PAIN: A RANDOMIZED DOUBLE-BLIND -CONTROLLED TRIAL
Protocol code: RI-B-2021-7300-07
Sponsor: Groupe Hospitalier Diaconesses Croix Saint Simon (Hospital/Clinic/Other health care facility). Phase: Therapeutic confirmatory (Phase III). Countries: France (authorised, recruitment pending).
Therapeutic area(s): Diseases [C] - Digestive System Diseases [C06]
Gender: Female, Male. Age: 18-64 years, 65+ years. Enrolment: 60.
Status: Authorised, recruitment pending. Decision date: 2024-12-11. Results received: No. Last updated: 2024-12-11.

Condition(s): chronic idiopathic ano-perineal pain
Product: LIDOCAINE AGUETTANT 10 mg/mL SANS CONSERVATEUR, Solution injectable, CHLORURE DE SODIUM PROAMP 0,9 %, solution injectable

Primary endpoint: Comparison between the two treatment arms (lidocaine versus saline) of the rate of patients with a reduction of at least 3 points on a visual analog pain scale (VAS) between inclusion and 1 month after the first injection.
Endpoint(s): Maintenance of positive response at 3 months, defined as a reduction of at least 3 VAS pain score points (compared with inclusion) 3 months after infiltration., Percentage of patients with a VAS score equal to 0 at 1 month after the first infiltration, Delta of the score on question 9 of the "modified" Concise Pain Questionnaire (CPQ) (French version of the Brief Pain Inventory) concerning the impact of pain, Delta of scores A (anxiety dimension) and D (depression dimension) on the HAD scale, Delta of the score for part A of the French version of the CSI central sensitization score

Source: https://euclinicaltrials.eu/ctis-public/view/2024-518148-19-00